EU clinical trial 2024-519404-27-00: EORTC-2427-BTG: Vorasidenib as maintenance treatment after first-line chemoradiotherapy in IDH-mutant grade 2 or 3 astrocytoma: a placebo-controlled, triple-blind, randomized phase III study (VIGOR)
Protocol code: EORTC-2427-BTG
Sponsor: Europese Organisatie Voor Onderzoek En Behandeling Van Kanker Organisation Europeenne Pour La Recherche Et Le Traitement Du Cancer European Organi (Patient organisation/association). Phase: Therapeutic confirmatory (Phase III). Countries: Germany (ongoing, recruiting), France (ongoing, recruiting), Italy (ongoing, recruiting), Austria (ongoing, recruiting), Netherlands (ongoing, recruiting), Spain (ongoing, recruiting), Czechia (ongoing, recruiting), Belgium (ongoing, recruiting).
Therapeutic area(s): Diseases [C] - Neoplasms [C04]
Gender: Female, Male. Age: 18-64 years, 65+ years. Enrolment: 247.
Status: Ongoing, recruiting. Start date (EU): 2026-01-16. Decision date: 2025-11-04. Results received: No. Last updated: 2026-05-04.
Decision dates by country: FR: 2025-11-06, ES: 2025-11-05, NL: 2025-11-06, IT: 2025-11-07, BE: 2025-11-06, DE: 2025-11-07, CZ: 2025-11-04, AT: 2025-11-10

Condition(s): IDH-mutant grade 2 or 3 astrocytoma
Product: Placebo tablets to match S95032 drug product are supplied as film-coated tablets for oral administration., S95032/AG-881, S95032/AG-881

Primary endpoint: The primary endpoint is PFS, as assessed locally from the date of enrolment using the RANO 2.0 criteria.
Endpoint(s): PFS by retrospective central radiological assessment from the date of enrolment using the RANO 2.0 criteria., PFS from the start of radiotherapy (both local and retrospective central radiological assessment) using RANO 2.0 criteria., OS from date of enrolment., Best response, overall response, disease control and complete response rate (both local and retrospective central radiological assessment) as well as duration of response using RANO 2.0 criteria., TTNI, Safety according to the CTCAE (NCI Common Terminology Criteria for Adverse Events) Version 5.0., HRQoL will be assessed, Neurological symptoms and signs, assessed using the NANO scale and measured by neurological progression-free survival (NPFS) and Seizure Control Composite Score Index., Neurocognitive function, as assessed by a test battery consisting of HVLT-R, TMT, COWA test, and MOS scale

Source: https://euclinicaltrials.eu/ctis-public/view/2024-519404-27-00